EU clinical trial 2023-505396-71-00: A Randomized, Placebo-Controlled, Double-Blind Study of XPro™ in Patients with Early Alzheimer’s Disease with Biomarkers of Inflammation
Protocol code: XPro1595-AD-02
Sponsor: Inmune Bio Inc. (Pharmaceutical company). Phase: Therapeutic exploratory (Phase II). Countries: Poland (ended), France (ended), Spain (ended), Germany (ended), Czechia (ended), Slovakia (ended).
Therapeutic area(s): Diseases [C] - Nervous System Diseases [C10]
Gender: Female, Male. Age: 18-64 years, 65+ years. Enrolment: 127.
Status: Ended. Start date (EU): 2024-03-01. End date (EU): 2025-05-05. Decision date: 2023-11-15. Results received: No. Last updated: 2025-02-20.
Decision dates by country: FR: 2023-11-20, ES: 2023-11-20, PL: 2023-11-15, CZ: 2024-05-24, DE: 2024-01-19, SK: 2024-06-07

Condition(s): Early Alzheimer’s Disease with Biomarkers of Inflammation
Product: Placebo to match XPro1595: The placebo contains the same ingredients as the active XPro1595 drug product except for the omission of the active ingredient., XPro1595

Primary endpoint: Change in the Early and Mild Alzheimer’s Cognitive Composite (EMACC) from Baseline to Week 24 in the following assessments: International Shopping List Test-Immediate Recall Digit Span Forward and Backward Category Fluency Test (DKEFS) Letter Fluency Test (DKEFS) Trail Making Test Parts A and B Digit Symbol Coding Test
Endpoint(s): Change from Baseline to Week 24 in Clinical Dementia Rating Scale (CDR) Change from Baseline to Week 24 in Everyday Cognition (E-Cog) Change from Baseline to Week 24 in (Neuropsychiatric Inventory [NPI-12] caregiver items)

Source: https://euclinicaltrials.eu/ctis-public/view/2023-505396-71-00